EU clinical trial 2024-516677-79-00: PHASE II CLINICAL TRIAL TO ESTABLISH THE SAFETY OF THE USE OF EXPANDED ALLOGENEIC FETAL UMBILICAL CORD STEM MESENCHYMAL CELLS IN PRETERM PATIENTS WITH BRONCHOPULMONARY DYSPLASIA
Protocol code: PULMESCELL-2
Sponsor: Fundacion Para La Investigacion Biomedica Del Hospital Universitario Ramon Y Cajal (Laboratory/Research/Testing facility). Phase: Therapeutic exploratory (Phase II). Countries: Spain (ongoing, recruiting).
Therapeutic area(s): Diseases [C] - Respiratory Tract Diseases [C08]
Gender: Female, Male. Age: 0-17 years. Enrolment: 75.
Status: Ongoing, recruiting. Start date (EU): 2024-01-11. Decision date: 2024-09-26. Results received: No. Last updated: 2026-02-20.

Condition(s): Premature patients with bronchopulmonary dysplasia
Product: EXPANDED ALLOGENEIC FETAL UMBILICAL CORD STEM MESENCHYMAL CELLS

Primary endpoint: Safety assessment: adverse reactions (AR)
Endpoint(s): Status at week 36 EPM (death/DBP grade 3). Diagnosis and stage of BPD at 36 weeks EPM according to Jensen´s classification (no BPD, grade 1, grade 2 or grade 3). Exitus at 36 and 40 weeks of EPM or at discharge (yes/no). Incidence of comorbidities derived from prematurity. Variations in the levels of biomarkers of inflammation, oxidative stress and lung damage with respect to baseline. Variations in the modified respiratory score and RSS score during therapy and up to week 36 EPM.

Source: https://euclinicaltrials.eu/ctis-public/view/2024-516677-79-00